EU clinical trial 2024-516102-36-00: RIFIREINS. Rituximab from the first episode of Minimal Change Nephrotic Syndrome for preventing relapse risk in adult patients
Protocol code: P170922J
Sponsor: Assistance Publique Hopitaux De Paris (Hospital/Clinic/Other health care facility). Phase: Therapeutic exploratory (Phase II). Countries: France (ongoing, recruitment ended).
Therapeutic area(s): Diseases [C] - Immune System Diseases [C20]
Gender: Female, Male. Age: 18-64 years. Enrolment: 148.
Status: Ongoing, recruitment ended. Start date (EU): 2020-07-29. Decision date: 2024-09-03. Results received: No. Last updated: 2025-02-26.

Condition(s): Minimal Change Nephrotic Syndrom
Product: PREDNISOLONE, MabThera 100 mg concentrate for solution for infusion, PREDNISONE, MabThera 500 mg concentrate for solution for infusion

Primary endpoint: Incidence of MCNS relapse during the 12 months following randomization defined by the recurrence of nephrotic syndrome (urine protein/creatinine ratio (UPCR) ≥ 300mg/mmol and decreased albumin level (< 30 g/L) in a patient who was in complete remission
Endpoint(s): The relapse rate at 18 months of follow-up after randomization, The type, frequency and the severity of adverse events (AEs) and serious adverse events (SAEs), The treatment burden assessed with the Treatment Burden Questionnaire, To assess potential risk factors of relapse, the following explanatory variables will be recorded (demographics, clinical characteristics, biological variables, renal pathologic findings)

Source: https://euclinicaltrials.eu/ctis-public/view/2024-516102-36-00